EU clinical trial 2023-504161-22-00: A Phase 2 Randomized, Double-Blind, Placebo-Controlled Study to Evaluate Efficacy and Safety of Deucravacitinib (BMS-986165) in Participants with Active Discoid and/or Subacute Cutaneous Lupus Erythematosus (DLE/SCLE)
Protocol code: IM011-132
Sponsor: Bristol-Myers Squibb Services Unlimited Company (Pharmaceutical company). Phase: Therapeutic exploratory (Phase II). Countries: France (ongoing, recruitment ended), Poland (ongoing, recruitment ended), Germany (ongoing, recruitment ended).
Therapeutic area(s): Diseases [C] - Immune System Diseases [C20]
Gender: Female, Male. Age: 18-64 years, 65+ years. Enrolment: 36.
Status: Ongoing, recruitment ended. Start date (EU): 2021-06-04. Decision date: 2023-08-22. Results received: No. Last updated: 2026-03-30.
Decision dates by country: PL: 2023-09-11, FR: 2023-08-22, DE: 2023-08-25

Condition(s): Active Discoid and/or Subacute Cutaneous Lupus Erythematosus (DLE/SCLE)
Product: Deucravacitinib 6 mg tablet, Deucravacitinib 3 mg tablet, deucravacitinib, deucravacitinib

Primary endpoint: Percentage change from baseline in CLASI activity (CLASIA) score
Endpoint(s): Percentage of participants with an improvement of ≥ 50% from baseline in the CLASI-A score (CLASI-50), Percentage of participants who have disease improvement as defined by a reduction in CLASI-A of ≥ 4 points from baseline, Mean change from baseline in CLASI-A score, Percentage of participants who have a Complete Response (CR) on CLASI-A defined as a score of "0", Number and proportion of participants experiencing SAEs, AEs (with severity and relationship of AEs), and abnormalities in laboratory testing, vital signs, and 12-lead ECGs

Source: https://euclinicaltrials.eu/ctis-public/view/2023-504161-22-00